EU clinical trial 2025-522045-21-00: A study in people with advanced cancer (solid tumours) to test different doses of BI 3810944 and to find out whether it helps
Protocol code: 1527-0001
Sponsor: Boehringer Ingelheim International GmbH (Pharmaceutical company). Phase: Human Pharmacology (Phase I)- First administration to humans. Countries: Belgium (authorised, recruitment pending), Netherlands (authorised, recruitment pending).
Therapeutic area(s): Diseases [C] - Neoplasms [C04]
Gender: Female, Male. Age: 18-64 years, 65+ years. Enrolment: 26.
Status: Authorised, recruitment pending. Decision date: 2025-11-14. Results received: No. Last updated: 2026-06-29.
Decision dates by country: BE: 2025-11-14, NL: 2025-11-17

Condition(s): Solid tumours, Melanoma

Source: https://euclinicaltrials.eu/ctis-public/view/2025-522045-21-00